EU clinical trial 2023-503280-42-00: A Phase 3, Open-label, Randomized, Noninferiority Trial of the Subcutaneous Formulation of Nivolumab Versus Intravenous Nivolumab in Participants With Advanced or Metastatic Clear Cell Renal Cell Carcinoma Who Had Received Prior Systemic Therapy
Protocol code: CA209-67T
Sponsor: Bristol-Myers Squibb Services Unlimited Company (Pharmaceutical company). Phase: Therapeutic confirmatory (Phase III). Countries: Italy (ended), Spain (ended), Finland (ended), Ireland (ended), Poland (ended), Romania (ended), Czechia (ended), France (ended), Portugal (ended).
Therapeutic area(s): Diseases [C] - Neoplasms [C04]
Gender: Female, Male. Age: 18-64 years, 65+ years. Enrolment: 134.
Status: Ended. Start date (EU): 2021-06-01. End date (EU): 2025-12-05. Decision date: 2024-07-31. Results received: No. Last updated: 2026-01-13.
Decision dates by country: PT: 2024-08-02, IT: 2024-08-12, FI: 2024-08-05, RO: 2024-08-01, ES: 2024-07-31, PL: 2024-08-04, CZ: 2024-08-01, FR: 2024-08-02, IE: 2024-07-31

Condition(s): Metastatic Clear Cell Renal Cell Carcinoma
Product: Nivolumab Subcutaneous, OPDIVO 10 mg/mL concentrate for solution for infusion.

Primary endpoint: Time-averaged serum concentration over 28 days (Cavgd28), Trough serum concentration at steady-state (Cminss)
Endpoint(s): - Objective response rate (ORR) by Blinded Independent Central Review (BICR) with a minimum of 6 months follow-up [ Time Frame: Up to 2 years 6 months ], - Trough serum concentration at day 28 (Cmind28) [ Time Frame: At 28 days ], - Maximum serum concentration after the first dose (Cmax1) [ Time Frame: Up to 7 days ], - Peak serum concentration at steady-state (Cmaxss) [ Time Frame: Up to 4 months ], - Steady-state average serum concentration (Cavgss) [ Time Frame: Up to 4 months ], - Observed trough nivolumab serum concentration (Ctrough) at Week 17 [ Time Frame: At Week 17 ], - Incidence of adverse events (AEs) [ Time Frame: Up to 2 years 3 months ], - Incidence of serious adverse events (SAEs) [ Time Frame: Up to 2 years 3 months ], - Incidence of AEs leading to discontinuation [ Time Frame: Up to 2 years ], - Incidence of deaths [ Time Frame: Up to 5 years ], - Incidence of clinically significant changes in clinical laboratory results: Hematology tests [ Time Frame: Up to 2 years 3 months ], - Incidence of clinically significant changes in clinical laboratory results: Chemistry panel tests [ Time Frame: Up to 2 years 3 months ], - Efficacy parameters: disease control rate (DCR) by BICR with a minimum of 6 months follow-up [ Time Frame: Up to 2 years 6 months ], - Efficacy parameters: DCR by BICR with a minimum of 12 months follow-up [ Time Frame: Up to 3 years ], - Efficacy parameters: DCR by BICR at end of study [ Time Frame: Up to 5 years ], - Efficacy parameters: duration of response (DOR) by BICR with a minimum of 6 months follow-up [ Time Frame: Up to 2 years 6 months ], - Efficacy parameters: DOR by BICR with a minimum of 12 months follow-up [ Time Frame: Up to 3 years ], - Efficacy parameters: DOR by BICR at end of study [ Time Frame: Up to 5 years, - Efficacy parameters: time to objective response (TTR) by BICR with a minimum of 6 months follow-up [ Time Frame: Up to 2 years 6 months ], - Efficacy parameters: TTR by BICR with a minimum of 12 months followup [ Time Frame: Up to 3 years ], - Efficacy parameters: TTR by BICR at end of study [ Time Frame: Up to 5 years ], - Efficacy parameters: progression-free survival (PFS) by BICR with a minimum of 6 months follow-up [ Time Frame: Up to 2 years 6 months ], - Efficacy parameters: PFS by BICR with a minimum of 12 months followup [ Time Frame: Up to 3 years ], - Efficacy parameters: PFS by BICR at end of study [ Time Frame: Up to 5 years ], - Efficacy parameters: overall survival (OS) with a minimum of 6 months follow-up [ Time Frame: Up to 2 years 6 months ], - Efficacy parameters: OS with a minimum of 12 months follow-up [ Time Frame: Up to 3 years ], - Efficacy parameters: OS at end of study [ Time Frame: Up to 5 years ], - Efficacy parameters: ORR by BICR with a minimum of 12 months follow-up [ Time Frame: Up to 3 years ], - Efficacy parameters: ORR by BICR at end of study [ Time Frame: Up to 5 years ], - Incidence of anaphylactic, hypersensitivity, and systemic infusion reactions [ Time Frame: Up to 2 years 3 months ], - Incidence of local injection- or infusion-site reactions [ Time Frame: Up to 2 years 3 months ], - Percentage of participants who develop anti-nivolumab antibodies, if applicable [ Time Frame: Up to 2 years 3 months ], - Percentage of participants who develop neutralizing antibodies, if applicable [ Time Frame: Up to 2 years 3 months ]

Source: https://euclinicaltrials.eu/ctis-public/view/2023-503280-42-00